EU clinical trial 2024-514238-19-00: Basket of Baskets: A Modular, Open-label, Phase II, Multicentre Study To Evaluate Targeted Agents in Molecularly Selected Populations With Advanced Solid Tumours
Protocol code: VHIO17002
Sponsor: Vall D Hebron Institute Of Oncology (Laboratory/Research/Testing facility). Phase: Therapeutic exploratory (Phase II). Countries: Sweden (ongoing, recruiting), Netherlands (ongoing, recruiting), Spain (ongoing, recruiting), Germany (ongoing, recruiting), France (ongoing, recruiting), Italy (ongoing, recruiting).
Therapeutic area(s): Diseases [C] - Neoplasms [C04]
Gender: Female, Male. Age: 18-64 years, 65+ years. Enrolment: 167.
Status: Ongoing, recruiting. Start date (EU): 2018-03-28. Decision date: 2024-10-01. Results received: No. Last updated: 2026-05-28.
Decision dates by country: IT: 2024-11-11, ES: 2024-10-01, DE: 2024-10-02, SE: 2024-10-02, NL: 2024-10-03, FR: 2024-10-09

Condition(s): Subjects with advanced solid tumour
Product: Tecentriq 1 200 mg concentrate for solution for infusion, JNJ-61186372, Futibatinib

Primary endpoint: Module 1, 2 & 3: • Overall response rate (ORR) or complete response (CR) by RECIST 1.1 of different targeted agents in molecularly selected small patient populations. Specific to Module 1: * For patients with prostate cancer in arm 1G: ORR at 12 weeks ofatezolizumab by a composite of biochemical and/or objective radiographic responses according to Prostate Cancer Working Group 3 (PCWG3) and RECIST 1.1. No specific primary endpoint in iProfiler (Part A) protocol.

Source: https://euclinicaltrials.eu/ctis-public/view/2024-514238-19-00